EU clinical trial 2023-508265-33-00: A double-blind, randomized, placebo-controlled multicenter study to investigate efficacy and safety of elinzanetant for the treatment of vasomotor symptoms caused by adjuvant endocrine therapy, over 52 weeks and optionally for additional up to 3.5 years in women with, or at high risk for developing hormone-receptor positive breast cancer
Protocol code: 21656
Sponsor: Bayer Consumer Care AG, Bayer AG (Pharmaceutical company). Phase: Therapeutic confirmatory (Phase III). Countries: Hungary (ongoing, recruitment ended), Finland (ongoing, recruitment ended), Poland (ongoing, recruitment ended), France (ongoing, recruitment ended), Spain (ongoing, recruitment ended), Portugal (ongoing, recruitment ended), Belgium (ongoing, recruitment ended), Romania (ongoing, recruitment ended), Ireland (ongoing, recruitment ended), Austria (ongoing, recruitment ended), Germany (ongoing, recruitment ended), Italy (ongoing, recruitment ended).
Therapeutic area(s): Diseases [C] - Female Urogenital Diseases and Pregnancy Complications [C13]
Gender: Female. Age: 18-64 years, 65+ years. Enrolment: 417.
Status: Ongoing, recruitment ended. Start date (EU): 2022-10-13. Decision date: 2024-02-20. Results received: No. Last updated: 2026-06-12.
Decision dates by country: FR: 2024-02-20, HU: 2024-02-20, IT: 2024-02-26, AT: 2024-03-26, PL: 2024-02-29, RO: 2024-02-22, ES: 2024-02-26, IE: 2024-02-20, FI: 2024-02-22, DE: 2024-02-21, BE: 2024-02-22, PT: 2024-02-21

Condition(s): Vasomotor symptoms caused by adjuvant endocrine therapy in women with, or at high risk for developing hormone-receptor positive breast cancer
Product: BAY 3427080 60 mg capsules placebo, BAY 3427080

Primary endpoint: Mean change in frequency of moderate to severe hot flash (HF) from baseline to Week 4 (assessed by hot flash daily diary [HFDD])., Mean change in frequency of moderate to severe HF from baseline to Week 12 (assessed by HFDD).
Endpoint(s): Mean change in severity of moderate to severe HF from baseline to Week 4 (assessed by HFDD)., Mean change in severity of moderate to severe HF from baseline to Week 12 (assessed by HFDD)., Mean change in frequency of moderate to severe HF from baseline to Week 1 (assessed by HFDD)., Mean change in frequency of moderate to severe HF from baseline over time., Mean change in patient-reported outcomes measurement information system sleep disturbance short form 8b (PROMIS SD SF 8b) total score from baseline to Week 12., Mean change in menopause specific quality of life scale (MENQOL) total score from baseline to Week 12.

Source: https://euclinicaltrials.eu/ctis-public/view/2023-508265-33-00